EU clinical trial 2022-501413-31-00: Immunogenicity of 9-valent HPV vaccine in immunocompromised children and adolescents
Protocol code: 19042021/22
Sponsor: Hospital Universitario La Paz (Hospital/Clinic/Other health care facility). Phase: Phase III and phase IV (Integrated). Countries: Spain (ongoing, recruitment ended).
Therapeutic area(s): Diseases [C] - Virus Diseases [C02]
Gender: Female, Male. Age: 0-17 years. Enrolment: 126.
Status: Ongoing, recruitment ended. Start date (EU): 2023-03-07. Decision date: 2022-09-29. Results received: No. Last updated: 2023-01-31.

Condition(s): Immunosuppressed patients
Product: Gardasil 9 suspension for injection in a pre filled syringe.Human Papillomavirus 9 valent Vaccine (Recombinant, adsorbed)

Primary endpoint: Seroconversion of subjects from baseline to month 7 and 12 (anti HPV titers at baseline, month 7 and month 12).
Endpoint(s): Age, immunosuppression category (HIV, SOT, HSCT, PCT), CD4/CD8 ratio, specific T cell response, TTV viral load

Source: https://euclinicaltrials.eu/ctis-public/view/2022-501413-31-00